EU clinical trial 2025-521784-12-00: Remimazolam versus propofol for deep sedation during Endoscopic Ultrasound (EUS) procedures. A randomized controlled trial.
Protocol code: RESPONSE
Sponsor: Ospedale San Raffaele S.r.l. (Hospital/Clinic/Other health care facility). Phase: Therapeutic use (Phase IV). Countries: Italy (ongoing, recruiting).
Therapeutic area(s): Diseases [C] - Neoplasms [C04]; Diseases [C] - Digestive System Diseases [C06]
Gender: Female, Male. Age: 18-64 years, 65+ years. Enrolment: 332.
Status: Ongoing, recruiting. Start date (EU): 2026-06-23. Decision date: 2025-11-11. Results received: No. Last updated: 2025-11-11.

Condition(s): Gastric and pancreatic cancer
Product: REMIMAZOLAM, PROPOFOL

Primary endpoint: The primary outcome will be a composite outcome of cardiorespiratory adverse events, Oxygen desaturation, defined as SpO2 < 90% or need to increase the basal oxygen flow., Respiratory depression (desaturation requiring interventions as chin-stiff, bag mask ventilation), Hypotension (mean arterial pressure < 65 mmHg or 20% drop in systolic blood pressure from preprocedural values), Arrhythmia, Tachycardia (HR > 100 beats for minute or a 25% increase from baseline HR) or bradycardia (<50 beats for minute), Need for intervention of anesthesiologist (according to the evaluation of endoscopist).
Endpoint(s): Evaluation of the quality of sedation, through specific questions (according to patients ‘and endoscopist’s point of view), Time needed to start the procedure, Awakening time, Time spent in recovery room, Time for hospital discharge, Pain at injection, Need for hospital admission, Need to crossover to other arm, Need for advanced respiratory support (tracheal intubation), Need to use additional hypnotic drugs, A cost-effectiveness analysis will be also performed considering costs related to used drugs, employment of personnel and occupation time of endoscopy and recovery room. We will also record all the other drugs used during and after sedation, the time to wake up after sedation (endoscopy room occupancy time) and the time to hospital discharge (recovery room occupancy time).

Source: https://euclinicaltrials.eu/ctis-public/view/2025-521784-12-00